EU clinical trial 2023-509969-20-00: This is clinical study to test, for the first time in people, the safety (any good or bad effects), how long the drug can stay in the body and if it can control the disease of people diagnosed with advanced cancer that has not responded to treatment, has returned after it has been treated, or cannot be treated by surgery, drugs, or any other known treatments.
Protocol code: CC-90010-ST-001
Sponsor: Celgene Corp. (Pharmaceutical company). Phase: Human Pharmacology (Phase I)- First administration to humans. Countries: Italy (ended), Spain (ended).
Therapeutic area(s): Diseases [C] - Neoplasms [C04]
Gender: Female, Male. Age: 18-64 years, 65+ years. Enrolment: 127.
Status: Ended. Start date (EU): 2017-07-24. End date (EU): 2024-09-06. End date: 2024-09-07. Decision date: 2024-02-21. Results received: No. Last updated: 2024-07-02.
Decision dates by country: IT: 2024-03-15, ES: 2024-03-15

Condition(s): Part C: advanced or unresectable STs (Spain only), Part B : r/r diffuse large B cell lymphoma (DLBCL) (Cohort 1), advanced basal cell carcinoma (BCC) (Cohort 2), r/r DLBCL under an alternative dosing regimen (Cohort 3), Part A: advanced or unresectable solid tumors (STs) and relapsed and/or refractory (r/r) advanced non-Hodgkin's lymphomas (NHLs)

Source: https://euclinicaltrials.eu/ctis-public/view/2023-509969-20-00